EU clinical trial 2024-513630-37-00: A Randomized, Double-Blind, Placebo Controlled Study of Venetoclax Co-Administered with Low Dose Cytarabine Versus Low Dose Cytarabine in Treatment Naïve Patients with Acute Myeloid Leukemia Who Are Ineligible for Intensive Chemotherapy
Protocol code: M16-043
Sponsor: AbbVie Deutschland GmbH & Co. KG (Pharmaceutical company). Phase: Therapeutic confirmatory (Phase III). Countries: France (ended).
Therapeutic area(s): Diseases [C] - Neoplasms [C04]
Gender: Female, Male. Age: 18-64 years, 65+ years. Enrolment: 1.
Status: Ended. Start date (EU): 2017-10-24. End date (EU): 2025-06-23. End date: 2025-08-21. Decision date: 2024-07-01. Results received: No. Last updated: 2024-07-01.

Condition(s): Acute Myeloid Leukemia
Product: Venetoclax, Venetoclax, Cytarabine 100 mg/ml Solution for Injection or Infusion, Matching Placebo for Venetoclax, Venetoclax

Primary endpoint: Overall Survival (OS)
Endpoint(s): CR + CRi rate, CR + CRi rate by initiation of Cycle 2., Patient Reported Outcomes Measurement Information System (PROMIS) Cancer Fatigue Short Form [SF] 7a., Global Health Status/Quality of Life (GHS/QoL) based on the European Organization for Research and Treatment of Cancer Quality of Life Questionnaire Core (EORTC QLQ-C30)

Source: https://euclinicaltrials.eu/ctis-public/view/2024-513630-37-00